EU clinical trial 2024-517762-42-01: A prospective multicentre single-arm study in adults to evaluate the safety and preliminary efficacy of the autologous 3D osteogenic implant NVD-003 for bone reconstruction for the treatment of recalcitrant lower limb nonunion.
Protocol code: NVD003-CLN01
Sponsor: Novadip Biosciences (Pharmaceutical company). Phase: Phase I and Phase II (Integrated)- First administration to humans. Countries: Belgium (ended), Luxembourg (ongoing, recruiting).
Therapeutic area(s): Diseases [C] - Musculoskeletal Diseases [C05]
Gender: Female, Male. Age: 18-64 years, 65+ years. Enrolment: 11.
Start date (EU): 2018-08-02. Decision date: 2025-01-23. Results received: No. Last updated: 2025-09-04.
Decision dates by country: BE: 2025-01-23, LU: 2025-01-24

Condition(s): recalcitrant lower limb nonunion
Product: NVD003

Primary endpoint: Safety: From graft implantation until completion of visit V7 • All Adverse Events (AEs) including Serious Adverse Events (SAEs), Adverse Events of Special Interest (AESI) and Procedure Related AE’s (PRAE)., Safety: At V2, V3, V4, V5, V6 and V7 • Vital signs abnormalities. • Physical examinations abnormalities. • Safety laboratories abnormalities.
Endpoint(s): Healing efficacy: Plain X-ray healing defined as 3 united cortices out of 4, on antero-posterior and lateral RX views, measured at 6 weeks (V3), 3 months (V4), 6 months (V5), 12 months (V6), at additional visits (V ADD, if no healing at 12 months after graft implant surgery) up to visit 7 (V7). The Radiographic Union Score (RUS) will be calculated, Healing efficacy: Computerized Tomography (CT)-scan healing defined as 3 united cortices out of 4, measured at 6, 12 and 24 months. The Tomography Union Score (TUS) will be calculated (see APPENDIX 7)., Healing efficacy: The average time from IMP grafting surgery (V1) till first observation of plain X-ray and CT-scan confirmed fracture healing (using the above definitions)., Healing efficacy: Investigator assessed clinical healing based on the overall clinical evaluation of the patient, including ability to bear weight, the pain score at palpation at the fracture site and the pain medication intake by the patient. Investigator assessed clinically healing will be evaluated from 6 weeks post-grafting onwards up to V7., Healing efficacy: The average time from IMP grafting surgery (V1) to Investigator assessed clinical healing (time from grafting surgery till first observation of investigator assessed clinical healing)., Grafting Surgery parameters: Duration of surgery (V1)., Grafting Surgery parameters: Duration of hospitalization (V1-V2)., Complications: Rate of subsequent surgical interventions (e.g. revision, removal, reoperation and/or supplemental fixation) measured at 12 and 24 months post-implant surgery., Quality of Life (QoL): Pain evaluation with the Brief Pain Inventory (Short Form) (BPI-SF) (see APPENDIX 3) (pain severity and pain interference with function) at screening and at 6 weeks, 3, 6, 12 and 24 months post-graft., Quality of Life (QoL): QoL questionnaire EuroQol-5 Dimensions (EQ-5D- 5L) (see APPENDIX 4) measured at screening and at 6 weeks, 3, 6, 12 and 24 months post-graft., Quality of Life (QoL): Overall Treatment Effect (OTE) (see APPENDIX 5) rating scale at 3, 6, 12 and 24 months post-graft., General Pre-graft implantation safety: All AEs including Serious Adverse Events (SAEs), Adverse Events of Special Interest (AESI) and Procedure Related AE’s (PRAE)., During the extended safety follow-up period (between 24 months FU visit and 5 years post-grafting surgery in Belgium and 10 years post-grafting surgery in Luxembourg): All Serious Adverse Events (SAEs).

Source: https://euclinicaltrials.eu/ctis-public/view/2024-517762-42-01